EU clinical trial 2024-517812-31-00: A low-interventional study to evaluate long-term effectiveness of real-world prophylactic treatment with efanesoctocog alfa on joint health in people with haemophilia A (ALTITUDE)
Protocol code: Sobi.BIVV001-005
Sponsor: Swedish Orphan Biovitrum AB (publ) (Pharmaceutical company). Phase: Therapeutic use (Phase IV). Countries: France (ongoing, recruiting), Sweden (ended), Spain (ongoing, recruiting), Ireland (ongoing, recruiting), Czechia (ongoing, recruiting), Germany (ongoing, recruiting), Croatia (ongoing, recruiting), Italy (ongoing, recruiting).
Therapeutic area(s): Diseases [C] - Congenital, Hereditary, and Neonatal Diseases and Abnormalities [C16]
Gender: Female, Male. Age: 0-17 years, 18-64 years, 65+ years. Enrolment: 175.
Start date (EU): 2025-05-21. Decision date: 2025-04-28. Results received: No. Last updated: 2026-05-26.
Decision dates by country: CZ: 2025-04-29, IE: 2025-05-02, ES: 2025-04-29, SE: 2025-04-29, HR: 2025-08-29, FR: 2025-04-28, DE: 2025-04-30, IT: 2025-07-02

Condition(s): Haemophilia A
Product: ALTUVOCT 250 IU powder and solvent for solution for injection, ALTUVOCT 3 000 IU powder and solvent for solution for injection, ALTUVOCT 500 IU powder and solvent for solution for injection, ALTUVOCT 2 000 IU powder and solvent for solution for injection, ALTUVOCT 1 000 IU powder and solvent for solution for injection, ALTUVOCT 4 000 IU powder and solvent for solution for injection

Primary endpoint: Annualised joint bleeding rate (AjBR) over the prospective period
Endpoint(s): 1. Annual Bleeding Rate over the prospective observation period, 2. Number of injections and total dose to control a bleeding event over the prospective observation period, 3. Change in HJHS from enrolment to Months 12, 24 and 36, 4. Target joint development, resolution, and recurrency on a patient and joint level during the period on efanesoctocog alfa

Source: https://euclinicaltrials.eu/ctis-public/view/2024-517812-31-00